EU clinical trial 2023-507661-26-00: A PHASE 1, OPEN-LABEL, RANDOMIZED, THREE-PERIOD, THREE-TREATMENT, BALANCED, SIX-SEQUENCE CROSSOVER STUDY TO DETERMINE THE RELATIVE BIOAVAILABILITY OF DIFFERENT HYDROMETHYLTHIONINE MESYLATE (HMTM) TABLET FORMULATIONS AND STRENGTHS IN HEALTHY ADULT SUBJECTS.
Protocol code: TRx-237-044
Sponsor: Taurx Therapeutics Limited (Pharmaceutical company). Phase: Human Pharmacology (Phase I)- Other. Countries: Netherlands (ended).
Therapeutic area(s): Phenomena and Processes [G] - Musculoskeletal and Neural Physiological Phenomena [G11]
Gender: Female, Male. Age: 18-64 years. Enrolment: 24.
Status: Ended. Start date (EU): 2024-03-18. End date (EU): 2024-05-17. Decision date: 2024-01-31. Results received: No. Last updated: 2024-01-31.

Condition(s): Alzheimer’s Disease

Source: https://euclinicaltrials.eu/ctis-public/view/2023-507661-26-00